EU clinical trial 2023-504013-68-00: A Study Evaluating the Safety, Pharmacokinetics, and Activity of RO7656594 in Patients with Advanced or Metastatic Prostate Cancer
Protocol code: GO44537
Sponsor: Genentech Inc. (Pharmaceutical company). Phase: Human Pharmacology (Phase I)- First administration to humans. Countries: Spain (ongoing, recruiting), France (ongoing, recruiting).
Therapeutic area(s): Diseases [C] - Neoplasms [C04]
Gender: Male. Age: 18-64 years, 65+ years. Enrolment: 22.
Status: Ongoing, recruiting. Start date (EU): 2024-09-06. Decision date: 2023-11-22. Results received: No. Last updated: 2026-02-26.
Decision dates by country: FR: 2023-11-27, ES: 2023-11-22

Condition(s): Advanced or Metastatic Prostate Cancer

Source: https://euclinicaltrials.eu/ctis-public/view/2023-504013-68-00